EU clinical trial 2024-514593-50-00: IMPACT OF INTRAVENOUS IRON TREATMENT OF PREOPERATIVE ANEMIA IN PATIENTS WITH LOWER EXTREMITY PERIPHERAL ARTERY DISEASE (IRONPAD)
Protocol code: IRONPAD
Sponsor: Asociacion Instituto De Investigacion Sanitaria Biobizkaia (Laboratory/Research/Testing facility). Phase: Therapeutic use (Phase IV). Countries: Spain (ongoing, recruitment ended).
Therapeutic area(s): Diseases [C] - Hemic and Lymphatic Diseases [C15]
Gender: Female, Male. Age: 18-64 years. Enrolment: 240.
Status: Ongoing, recruitment ended. Start date (EU): 2019-06-06. Decision date: 2024-05-22. Results received: No. Last updated: 2024-05-22.

Condition(s): Anemia in patients with chronic ischemia of the lower limb ischemia
Product: Ferinject 50 mg/ml dispersión inyectable y para perfusión

Primary endpoint: Reduce the incidence of transfusion from randomization up to 30 days after the main surgery in patients with anemia who undergo revascularization surgery with chronic lower limb ischemia
Endpoint(s): - Establish the optimal preoperative time of highest yield of iv iron to increase HB. - Changes and evolution of hemoglobin during admission; difference in Hb between inclusion, intervention and discharge. Hb 30 days after discharge. - Impact of anemia and its treatment on length of hospital stay, morbimortality and quality of life during admission and first 30 postoperative days

Source: https://euclinicaltrials.eu/ctis-public/view/2024-514593-50-00